EU clinical trial 2023-508770-28-00: AN EXPLORATORY, MULTICENTER, RANDOMIZED,DOUBLE BLIND STUDY OF CLINICAL OUTCOMES,TOLERABILITY, AND SAFETY OF 2 DOSES OF ORAL PANTOPRAZOLE IN PEDIATRIC PARTICIPANTS AGED 1 TO 11 YEARS AND 12 TO 17 YEARS WHO REQUIRE MAINTENANCE THERAPY FOR HEALED EROSIVE ESOPHAGITIS
Protocol code: B1791094
Sponsor: Pfizer Inc. (Pharmaceutical company). Phase: Therapeutic exploratory (Phase II). Countries: Slovakia (ended), Belgium (ended).
Therapeutic area(s): Diseases [C] - Digestive System Diseases [C06]
Gender: Female, Male. Age: 0-17 years. Enrolment: 18.
Status: Ended. Start date (EU): 2021-10-05. End date (EU): 2025-11-05. End date: 2025-12-16. Decision date: 2023-12-20. Results received: Yes. Last updated: 2025-05-09.
Decision dates by country: BE: 2023-12-21, SK: 2023-12-20

Condition(s): EROSIVE ESOPHAGITIS
Product: The placebo for the pantoprazole sodium 40 mg, 20 mg, 10 mg and 5 mg delayed release granules in HPMC capsules, PANTOPRAZOLE, PANTOPRAZOLE, PANTOPRAZOLE, PANTOPRAZOLE

Primary endpoint: Endoscopically confirmed maintenance of healing of erosive esophagitis at Week 24
Endpoint(s): Safety and tolerability will be assessed by physical examinations, AE monitoring, clinical laboratory measurements, blood pressure, and pulse rate.

Source: https://euclinicaltrials.eu/ctis-public/view/2023-508770-28-00